EU clinical trial 2024-513498-36-00: A Phase 2 open-label imaging study to explore the effects of sonelokimab in patients with active axial spondyloarthritis
Protocol code: M1095-axSpA-202
Sponsor: MoonLake Immunotherapeutics AG (Pharmaceutical company). Phase: Therapeutic exploratory (Phase II). Countries: Germany (ended).
Therapeutic area(s): Diseases [C] - Musculoskeletal Diseases [C05]
Gender: Female, Male. Age: 18-64 years, 65+ years. Enrolment: 25.
Status: Ended. Start date (EU): 2024-12-23. End date (EU): 2026-01-05. Decision date: 2024-11-18. Results received: No. Last updated: 2025-09-04.

Condition(s): axial spondyloarthritis
Product: Sonelokimab

Primary endpoint: Change from baseline in 18F-NaF SUVmax signals at Week 12 in the sacroiliac joints (SIJ) and spine as detected by PET scan.
Endpoint(s): Change from baseline in 18F-NaF SUVmean signals at Week 12 in the SIJ and spine as detected by PET scan., Change from baseline in the number of SIJ quadrants and vertebral corners with 18F-NaF uptake at Week 12 as detected by PET scan., Change from baseline in Spondyloarthritis Research Consortium of Canada (SPARCC) MRI score in SIJ and spine (separately) at Week 12., Proportion of participants with a decrease, no change or increase from baseline in SPARCC MRI score in SIJ and spine (separately) at Week 12., Change from baseline in sacroiliac joint structural (SSS) score at Week 12., Proportion of participants with a decrease, no change or increase from baseline in SSS score at Week 12., Change from baseline in Ankylosing Spondylitis Disease Activity Creactive protein (ASDAS-CRP) at Week 12., Proportion of participants with ASDAS status (inactive disease, moderate, high, and very high disease activity) over 12 weeks., Proportion of participants who achieve ASDAS clinically important improvements at Week 12., Proportion of participants who achieve Assessment of Spondyloarthritis International Society (ASAS) 20 and ASAS40 response at Week 12., Change from baseline in Physician’s Global Assessment of Disease Activity (PhGADA) score over 12 weeks., Change from baseline in Bath Ankylosing Spondylitis Disease Activity Index (BASDAI) score over 12 weeks., Change from baseline in swollen joint count of 66 joints/tender joint count of 68 joints (SJC66/TJC68) over 12 weeks., Change from baseline in Bath Ankylosing Spondylitis Functional Index (BASFI) score over 12 weeks., Change from baseline in Bath Ankylosing Spondylitis Metrology Index (BASMI) (linear) score over 12 weeks., Change from baseline in Maastricht Ankylosing Spondylitis Enthesitis Score (MASES) over 12 weeks., Change from baseline at Week 12 in: o Patient’s Global Assessment of Disease Activity (PtGADA)-NRS o Work Productivity and Activity Impairment (WPAI) domain scores o ASAS-Health Index (ASAS-HI)., Change from baseline in Functional Assessment of Chronic Illness Therapy (FACIT)-Fatigue score at Week 4 and Week 12., Change from baseline in total and nocturnal spinal pain as assessed on a numerical rating scale (NRS) over 12 weeks., Incidence, seriousness, relatedness, and severity of adverse events (AEs) and treatment-emergent adverse events (TEAEs) over 16 weeks., TEAEs /AEs leading to study withdrawal over 16 weeks., Adverse events of special interest (AESIs) over 16 weeks., Abnormal laboratory parameters (hematology, clinical chemistry, urinalysis) over 16 weeks., PK of sonelokimab (trough levels), Antidrug antibodies, Change from baseline in exploratory biomarkers levels over 12 weeks.

Source: https://euclinicaltrials.eu/ctis-public/view/2024-513498-36-00